EU clinical trial 2024-516500-42-00: An open label, balanced, randomized, two-treatment, two-period, two-sequence, single-dose, crossover, bioequivalence study comparing Brivaracetam Tablets Ph. Eur. 100 mg, manufactured by Sun Pharmaceutical Industries Limited, India with Briviact (brivaracetam) 100 mg film-coated tablets, Marketing Authorisation Holder: UCB Pharma S.A., Allée de la Recherche 60, B-1070 Bruxelles, Belgium; Manufactured by UCB Pharma S.A., Chemin du Foriest, B-1420 Braine-l’Alleud, Belgium, in healthy adult, human subjects under fasting condition.
Protocol code: BRIVA-10-24
Sponsor: Sun Pharmaceutical Industries Limited (Pharmaceutical company). Phase: Human Pharmacology (Phase I)- Bioequivalence Study. Countries: Romania (ended).
Therapeutic area(s): Diseases [C] - Nervous System Diseases [C10]
Gender: Female, Male. Age: 18-64 years. Enrolment: 36.
Status: Ended. Start date (EU): 2025-03-13. End date (EU): 2025-04-10. Decision date: 2024-12-16. Results received: No. Last updated: 2024-12-16.

Condition(s): Epilepsy

Source: https://euclinicaltrials.eu/ctis-public/view/2024-516500-42-00